EU clinical trial 2022-500295-60-00: An ALFA 2101 multicenter randomized phase II study: CPX-351 versus intensive chemotherapy in patients with de novo intermediate or adverse risk AML stratified by genomics
Protocol code: 21-PP-26
Sponsor: Centre Hospitalier Universitaire De Nice (Hospital/Clinic/Other health care facility). Phase: Therapeutic exploratory (Phase II). Countries: France (ongoing, recruiting).
Therapeutic area(s): Diseases [C] - Neoplasms [C04]
Gender: Female, Male. Age: 18-64 years, 65+ years. Enrolment: 248.
Status: Ongoing, recruiting. Start date (EU): 2022-09-15. Decision date: 2022-07-18. Results received: No. Last updated: 2026-03-10.

Condition(s): Acute Myeloid Leukemia
Product: CYTARABINE, Vyxeos Liposomal 44 mg/100 mg powder for concentrate for solution for infusion., IDARUBICIN

Primary endpoint: To compare the proportion of patients achieving a CR/CRi with a flow based MRD < 10-3 in the bone marrow aspirate using the LAIP/DfN method after the first course of induction therapy, at D1 of (or the day before) the first consolidation cycle in the experimental arm (induction by CPX-351) and in the control arm (induction by 3+7, idarubicine and cytarabine).
Endpoint(s): To compare the proportion of patients achieving as best response a CR/CRi with a flow based MRD threshold < 10-3 in the bone marrow aspirate using the LAIP/Dfn method in the experimental arm (induction by CPX-351) and in the control arm (conventional intensive chemotherapy), regardless of the number of treatment courses administered before to achieve this level of response., To compare between stratified randomization arms the flow-based MRD quantified in the bone marrow according to both the LAIP/DfN method and the LSC method at D1 of (or the day before) the third cycle of treatment (consolidation 1 or 2 according the need for second induction course), and 28-42 days after the last cycle of consolidation or before allogeneic-HSCT, if any., To compare between the bone marrow and the peripheral blood the results of flow-based MRD quantified according to both LAIP/DfN method and the LSC methods at D1 of (or the day before) the first cycle of consolidation, the second cycle of consolidation (or first cycle of consolidation after a successful salvage therapy), and 28-42 days after the last cycle of consolidation or before allogeneic-HSCT, if any., To compare between the randomization arms and between strata the results of NGS-based MRD at D1 of (or the day before) the first cycle of consolidation (or of salvage therapy), at D1 of the second cycle of consolidation (or first cycle of consolidation after a successful salvage therapy), and 28-42 days after the last cycle of consolidation or before allogeneic-HSCT, if any., - Overall response rate, and rate of CR (complete remission), CRi (complete remission with incomplete hematologic recovery) as defined in 2017 ELN recommendations - Cumulative incidence of allogeneic HSCT - Early mortality at D30, D60, D100 after the randomization - Overall Survival (with and without censoring at allo-HSCT), - Relapse-Free Survival (with and without censoring at allo-HSCT) - Event-Free Survival (with and without censoring at allo-HSCT) - Cumulative Incidence of Relapse (with and without censoring at allo-HSCT) - Hematological and non-hematological toxicity profile and safety using the NCI- common toxicity criteria (CTCAE) version 5.0 of November 2017 - Duration of hospitalization related to each cycle of treatment (induction and consolidation)., Genomic correlations: To compare between both randomization arms (CPX-351 and conventional intensive chemotherapy) and between strata: o Changes of the genomic landscape with the treatment o Association between the AML somatic mutations (documented with their allele frequency) and OS and RFS, Quality of life reported by the patient according to the EORTC QLQ-C30 questionnaire, o Secondary-type mutational profile at screening as determined by Lindsley et al o Centralized functional flow cytometry assays at baseline be carried on peripheral blood or bone marrow aspirate at the THEMA Lab (Hopital Saint-Louis), including o P-gp activity at baseline (multidrug resistance [MDR] phenotype) o Mitochondrial priming and BCL-2 dependence (optionally, if adequate biological material), Flow MRD o Changes of the phenotype of LSC and hematopoietic progenitors before, during, after the treatment in order to identify a potential correlation with drug resistance o Comparaison between classical conventional analysis of MRD flow and unsupervised strategy of MRD flow

Source: https://euclinicaltrials.eu/ctis-public/view/2022-500295-60-00